EU clinical trial 2024-517600-11-01: MidregiOnal proatrial natriuretic peptide to guide SEcondary Stroke prevention: The MOSES-study. An international, multicentre, randomised-controlled, two-arm, assessor-blinded trial.
Protocol code: MOSES
Sponsor: Universitaetsspital Basel (Hospital/Clinic/Other health care facility). Phase: Therapeutic confirmatory (Phase III). Countries: Greece (authorised, recruitment pending), Spain (authorised, recruitment pending).
Therapeutic area(s): Diseases [C] - Cardiovascular Diseases [C14]
Gender: Female, Male. Age: 18-64 years, 65+ years. Enrolment: 190.
Status: Authorised, recruitment pending. Decision date: 2025-01-17. Results received: No. Last updated: 2026-06-03.
Decision dates by country: ES: 2025-01-17, GR: 2025-01-23

Condition(s): Acute ischemic stroke
Product: Eliquis 5 mg film-coated tablets, Eliquis 2.5 mg film-coated tablets, Plavix 75 mg film-coated tablets, Pradaxa 110 mg hard capsules, Lixiana 30 mg film-coated tablets, Aspirine 100, 100 mg Tabletten, Lixiana 60 mg film-coated tablets, Pradaxa 150 mg hard capsules

Primary endpoint: The primary outcome measure is the time to any recurrent stroke within 1 year after the index ischemic stroke.
Endpoint(s): Composite of major bleeding, recurrent stroke and/or vascular death (whichever occurs first) within 1 year after the index ischemic stroke; single components of the composite outcome above

Source: https://euclinicaltrials.eu/ctis-public/view/2024-517600-11-01